EU clinical trial 2025-522111-42-02: Long-term muscle synthetic effects of intradialytic parenteral nutrition in chronic hemodialysis patients
Sponsor: Erasmus Universitair Medisch Centrum Rotterdam (Erasmus MC) (Hospital/Clinic/Other health care facility). Phase: Therapeutic use (Phase IV). Countries: Netherlands (authorised, recruitment pending).
Therapeutic area(s): Diseases [C] - Nutritional and Metabolic Diseases [C18]
Gender: Female, Male. Age: 18-64 years, 65+ years. Enrolment: 20.
Status: Authorised, recruitment pending. Decision date: 2025-10-27. Results received: No. Last updated: 2026-07-07.

Condition(s): muscle protein turnover hemodialysis
Product: COMBINATIONS

Primary endpoint: Difference in myofibrillar fractional synthetic rate during a one-week treatment with IDPN versus control
Endpoint(s): 1. Intradialytic forearm amino acid balance, 2. difference in the loss of amino acids in the dialysate during a one-week treatment with IDPN versus control period, 3. Effects of IDPN on intradialytic blood pressure and cardiac output.

Source: https://euclinicaltrials.eu/ctis-public/view/2025-522111-42-02